EU clinical trial 2023-505650-17-00: A Randomized, Double-blind, Placebo-controlled Clinical Study to Evaluate Mavacamten in Adolescents (age 12 years to < 18 years) with Symptomatic Obstructive Hypertrophic Cardiomyopathy (SCOUT-HCM)
Protocol code: CV027-010
Sponsor: Bristol-Myers Squibb Services Unlimited Company (Pharmaceutical company). Phase: Therapeutic confirmatory (Phase III). Countries: Germany (ongoing, recruitment ended), Spain (ongoing, recruitment ended), Italy (ongoing, recruitment ended), Ireland (ongoing, recruitment ended), France (ongoing, recruitment ended).
Therapeutic area(s): Diseases [C] - Cardiovascular Diseases [C14]
Gender: Female, Male. Age: 0-17 years. Enrolment: 11.
Status: Ongoing, recruitment ended. Start date (EU): 2024-08-27. Decision date: 2024-04-25. Results received: No. Last updated: 2026-07-06.
Decision dates by country: DE: 2024-04-25, IT: 2024-04-30, ES: 2024-04-29, IE: 2024-05-03, FR: 2024-05-03

Condition(s): Symptomatic Obstructive Hypertrophic Cardiomyopathy
Product: Mavacamten, Mavacamten, Mavacamten, Mavacamten, Mavacamten, "myk-461 capsules, placebo is a solid oral dosage form in size 2 gelatin capsules each containing 120 mg of an excipient blend. it is intended as a placebo to match myk-461 capsules of all active strengths"

Primary endpoint: Change from baseline in Valsalva LVOT gradient at Week 28
Endpoint(s): Change from baseline in the following at Week 28: 1) Resting LVOT gradient 2) Post-exercise peak LVOT gradient 3) Maximal wall thickness 4) Ratio between early mitral inflow velocity and mitral annular early diastolic velocity (E/e’), Proportion of participants achieving an increase from baseline to Week 28 in peak oxygen uptake test (pVO2), Proportion of participants achieving a reduction from baseline to Week 28 in maximal LVOT gradient to < 30 mmHg, Proportion of participants with at least 1 class improvement in New York Heart Association (NYHA) class from baseline to Week 28, Proportion of participants with at least 1 grade improvement in mitral regurgitation at Week 28 Incidence of treatment emergent adverse events (TEAEs) and treatment emergent serious adverse events (TESAEs), Change from baseline in QT interval on electrocardiogram at Week 28, Incidence of left ventricular ejection fraction (LVEF) ≤ 30%, Incidence of LVEF < 50%, Summary of plasma concentrations by visit (Ctrough and post dose), Cmax and AUC using sparse sampling utilizing population PK approach, Proportion of participants who evaluate taste and swallowability as neutral or better using taste and swallowability scales at Day 1 and Week 11, Change from baseline in the HCMSQ SoB domain at Week 28

Source: https://euclinicaltrials.eu/ctis-public/view/2023-505650-17-00